EU clinical trial 2023-510148-19-00: A Phase IIb Two-cohort, Randomised, Placebo-controlled, Double-blind, Multi-centre, Dose-ranging Study of AZD5462 in Stable Patients with Chronic Heart Failure
Protocol code: D9090C00008
Sponsor: AstraZeneca AB (Pharmaceutical company). Phase: Therapeutic exploratory (Phase II). Countries: Bulgaria (ended), Czechia (ended), Poland (ended), Denmark (ended), Netherlands (ended), Hungary (ended), Slovakia (ended).
Therapeutic area(s): Diseases [C] - Cardiovascular Diseases [C14]
Gender: Female, Male. Age: 18-64 years, 65+ years. Enrolment: 235.
Status: Ended. Start date (EU): 2024-07-03. End date (EU): 2026-01-21. End date: 2026-02-10. Decision date: 2024-07-02. Results received: No. Last updated: 2025-12-01.
Decision dates by country: DK: 2024-07-02, CZ: 2024-07-03, NL: 2024-07-04, BG: 2024-07-05, SK: 2024-07-02, PL: 2024-07-05, HU: 2024-07-03

Condition(s): Chronic Heart Failure
Product: AZD5462, AZD5462, The AZD5462 film-coated tablet placebo contains microcrystalline cellulose, magnesium stearate, polyvinyl alcohol, titanium dioxide, macrogol (polyethylene glycol) and talc. It is supplied in the same pack as the active and should be stored according to instructions on the label., AZD5462

Primary endpoint: Change in echocardiographic measurements from Baseline to Week 25
Endpoint(s): Change in echocardiographic measurements from Baseline to Week 13 and Week 25, • Change in Health Status from Baseline to Week 3, Week 5, Week 13, and Week 25 • Change in NYHA FC from Baseline to Week 25, Change echocardiographic measurements from baseline to week 25, Change in cardiac biomarkers from Baseline to Week 5, Week 13, and Week 25, AZD5462 plasma PK concentrations

Source: https://euclinicaltrials.eu/ctis-public/view/2023-510148-19-00